EU clinical trial 2024-513008-32-00: A Phase 2 Randomized Study to Evaluate the Safety, Efficacy, and Optimal Dose of Telisotuzumab Adizutecan in Combination with Fluorouracil, Leucovorin, and Budigalimab as First-Line Treatment in Subjects with Locally Advanced Unresectable or Metastatic Gastric, Gastroesophageal Junction, or Esophageal Adenocarcinoma (AndroMETa-GEA-977)
Protocol code: M24-977
Sponsor: AbbVie Deutschland GmbH & Co. KG (Pharmaceutical company). Phase: Therapeutic exploratory (Phase II). Countries: Belgium (ongoing, recruitment ended), Germany (ongoing, recruitment ended), Spain (ongoing, recruitment ended).
Therapeutic area(s): Diseases [C] - Digestive System Diseases [C06]
Gender: Female, Male. Age: 18-64 years, 65+ years. Enrolment: 50.
Status: Ongoing, recruitment ended. Start date (EU): 2025-12-17. Decision date: 2025-03-24. Results received: No. Last updated: 2026-07-10.
Decision dates by country: BE: 2025-03-24, ES: 2025-03-24, DE: 2025-03-25

Condition(s): Adenocarcinoma of the gastroesophageal junction
Product: Telisotuzumab adizutecan, Oxaliplatin 5 mg/ml concentrate for solution for infusion, FOLINIC ACID, Fluorouracil 50mg/ml Injection., Eftozanermin alfa

Primary endpoint: PFS as assessed by investigator: PFS is defined as the time from the first dose of study drug to the first occurrence of radiographic progression based on Response Evaluation Criteria in Solid Tumors (RECIST) version 1.1 as determined by investigator or death from any cause, whichever occurs earlier. Subjects with no PFS event will be censored at the last evaluable radiographic assessment. Subjects with no event and no evaluable post-baseline assessment will be censored at the first dose date, Overall survival (OR) as assessed by investigator: Confirmed complete response (CR) or confirmed partial response (PR) as assessed by investigator per RECIST version 1.1. Response will need to be confirmed by a repeat assessment no less than 28 days from the first documented response.
Endpoint(s): Duration of Response (DoR) as assessed by investigator: The time from the first documented CR or PR to the first occurrence of radiographic progression per RECIST version 1.1 as determined by investigator or death from any cause, whichever occurs first. DoR is defined for subjects with confirmed CR/PR., Disease control (DC) as assessed by investigator: best overall response of confirmed CR or confirmed PR, or stable disease (SD) (with a minimum duration of 16 weeks) based on RECIST, version 1.1 as determined by the investigator, Overall survival (OR) is defined as the time from first dose of study drug to the event of death from any cause. Subjects with no documented death will be censored at the last known alive date.

Source: https://euclinicaltrials.eu/ctis-public/view/2024-513008-32-00